EU clinical trial 2025-521730-28-00: A Phase 2, Multicenter, Randomized, Double blind, Placebo-controlled Study to Assess the Efficacy, Safety, and Tolerability of NGM120 in Participants with Colorectal Cancer who have Cancer Cachexia
Protocol code: 120-CX-202
Sponsor: Ngm Biopharmaceuticals Inc. (Pharmaceutical company). Phase: Therapeutic exploratory (Phase II). Countries: Czechia (ongoing, recruiting), Slovakia (ongoing, recruiting), Poland (ongoing, recruiting), Hungary (ongoing, recruiting), Bulgaria (ongoing, recruiting).
Therapeutic area(s): Diseases [C] - Nutritional and Metabolic Diseases [C18]
Gender: Female, Male. Age: 18-64 years, 65+ years. Enrolment: 54.
Status: Ongoing, recruiting. Start date (EU): 2026-03-30. Decision date: 2025-10-21. Results received: No. Last updated: 2026-05-05.
Decision dates by country: SK: 2025-10-21, PL: 2025-10-26, CZ: 2025-10-22, BG: 2025-10-27, HU: 2025-10-22

Condition(s): Colorectal Cancer with Cancer Cachexia
Product: NGM120, placebo for NGM120

Primary endpoint: Change from baseline in body weight at Week 12, Treatment-emergent adverse events (TEAEs) characterized by type, frequency, severity, timing, seriousness, and relationship to study drug
Endpoint(s): Key: Change from baseline in body weight at Week 16, Change from baseline over time in: − FAACT sub-scale scores (FAACT-ACS, FAACT-5IASS) − PROMIS (fatigue 7a & physical function 8c) − PGI-S and PGI-C (appetite and fatigue) − PGI-S and PGI-C (physical activity and walking), Treatment-emergent adverse events (TEAEs) characterized by type, frequency, severity, timing, seriousness, and relationship to study drug, Change in body weight over time, Serum concentration and PK parameters of NGM120., Incidence and titer of ADA and NAb over time.

Source: https://euclinicaltrials.eu/ctis-public/view/2025-521730-28-00